EU clinical trial 2023-506215-17-00: Clinical Trial on the Use of Cell Therapy in the Treatment of Patients With Amyotrophic Lateral Sclerosis (TCIM-ELAII)
Protocol code: IMB-TCIM/ELA II-2019
Sponsor: Fundacion Para La Formacion E Investigacion Sanitaria De La Region De Murcia (Educational Institution). Phase: Therapeutic exploratory (Phase II). Countries: Spain (ongoing, recruiting).
Therapeutic area(s): Diseases [C] - Musculoskeletal Diseases [C05]
Gender: Female, Male. Age: 18-64 years, 65+ years. Enrolment: 100.
Status: Ongoing, recruiting. Start date (EU): 2021-05-03. Decision date: 2024-11-05. Results received: No. Last updated: 2024-11-05.

Condition(s): Amyotrophic Lateral Sclerosis

Source: https://euclinicaltrials.eu/ctis-public/view/2023-506215-17-00